EU clinical trial 2024-517726-26-00: Impact of Intraovarian Injection of Platelet-Rich Plasma and Growth Factors on IVF Outcomes in Patients with Low Ovarian Reserve: A Randomized Controlled Trial
Sponsor: Ivi Alicante S.L. (Hospital/Clinic/Other health care facility). Phase: Therapeutic confirmatory (Phase III). Countries: Spain (authorised, recruitment pending).
Therapeutic area(s): Phenomena and Processes [G] - Reproductive and Urinary Physiological Phenomena [G08]
Gender: Female. Age: 18-64 years. Enrolment: 160.
Status: Authorised, recruitment pending. Decision date: 2025-07-30. Results received: No. Last updated: 2025-07-30.

Condition(s): Female Infertility
Product: PLATELET CONCENTRATE, Suero Fisiológico Braun 0,9% disolvente para uso parenteral Cloruro de sodio

Primary endpoint: number of oocytes retrieved after intraovarian administration of the study treatment, PRGF Endoret® vs. placebo

Source: https://euclinicaltrials.eu/ctis-public/view/2024-517726-26-00